EU clinical trial 2025-524210-28-00: A Study to Track How the Healthy Male Participants Handles the New Oral Drug RO7795081 for Weight Management and Diabetes
Protocol code: BP45932
Sponsor: F. Hoffmann-La Roche AG (Pharmaceutical company). Phase: Human Pharmacology (Phase I)- Other. Countries: Netherlands (ended).
Therapeutic area(s): Health Care [N] - Population Characteristics [N01]
Gender: Male. Age: 18-64 years. Enrolment: 10.
Status: Ended. Start date (EU): 2026-02-17. End date (EU): 2026-04-17. Decision date: 2026-02-11. Results received: No. Last updated: 2026-03-24.

Source: https://euclinicaltrials.eu/ctis-public/view/2025-524210-28-00